EU clinical trial 2023-510298-33-00: A Phase 2 Open-label Extension Study for Subjects with Prostate Cancer Who Previously Participated in an Enzalutamide Clinical Study
Protocol code: 9785-CL-0123
Sponsor: Astellas Pharma Global Development Inc. (Pharmaceutical company). Phase: Therapeutic exploratory (Phase II). Countries: Germany (ongoing, recruitment ended), Spain (ongoing, recruitment ended), Romania (ongoing, recruitment ended), Belgium (ongoing, recruitment ended), Italy (ongoing, recruitment ended), Sweden (ongoing, recruitment ended), Slovakia (ongoing, recruitment ended), Czechia (ongoing, recruitment ended), Austria (ongoing, recruitment ended), France (ongoing, recruitment ended), Norway (ongoing, recruitment ended), Netherlands (ongoing, recruitment ended), Poland (ongoing, recruiting), Finland (ongoing, recruitment ended), Denmark (ongoing, recruitment ended).
Therapeutic area(s): Diseases [C] - Neoplasms [C04]
Gender: Male. Age: 18-64 years, 65+ years. Enrolment: 251.
Start date (EU): 2016-11-29. Decision date: 2024-04-09. Results received: No. Last updated: 2026-04-07.
Decision dates by country: NL: 2024-04-09, BE: 2024-04-18, CZ: 2024-04-10, SE: 2024-04-10, AT: 2024-04-15, IT: 2024-04-11, DE: 2024-04-10, SK: 2024-04-09, RO: 2024-04-16, FI: 2024-04-10, NO: 2024-04-11, DK: 2024-04-10, ES: 2024-04-12, FR: 2024-04-12, PL: 2024-04-12

Condition(s): Prostate Cancer
Product: PREDNISONE, ABIRATERONE, MDV3100

Source: https://euclinicaltrials.eu/ctis-public/view/2023-510298-33-00